EU clinical trial 2025-520627-25-00: A single centre parallel-group randomized control trial of Magnetic Resonance Assessment of Variations in Effects of anaesthesia on renaL perfusion in children
Sponsor: Region Uppsala (Hospital/Clinic/Other health care facility). Phase: Therapeutic use (Phase IV). Countries: Sweden (authorised, recruitment pending).
Therapeutic area(s): Phenomena and Processes [G] - Physiological processes [G07]; Diseases [C] - Cardiovascular Diseases [C14]
Gender: Female, Male. Age: 0-17 years. Enrolment: 50.
Status: Authorised, recruitment pending. Decision date: 2025-09-26. Results received: No. Last updated: 2025-09-26.

Condition(s): Post-operative Acute Kidney Injury
Product: PROPOFOL, SEVOFLURANE

Primary endpoint: Differences in RBF, as measured by phase contrast imaging with mpMRI, between propofol and sevoflurane anesthesia.
Endpoint(s): The difference plasma renin concentration, measured by a blood sample, between propofol and sevoflurane anaesthesia, The difference in relation of RBF to systemic non-invasive blood pressure, between propofol and sevoflurane anaesthesia, Differences in regional and global renal oxygenation, as measured by Blood Oxygen Level Dependent (BOLD) signal via mpMRI, between propofol and sevoflurane anaesthesia., Differences in regional renal tissue perfusion, as measured by arterial spin labelling (ASL) with mpMRI, between propofol and sevoflurane anaesthesia

Source: https://euclinicaltrials.eu/ctis-public/view/2025-520627-25-00